EU clinical trial 2024-519532-16-00: A phase I/II study of CAR-expressing Allogenic iPSC derived NK cells for treatment of autoiMmune disease by B cELl depletion - CARAMEL
Sponsor: Universitaetsklinikum Erlangen AöR (Hospital/Clinic/Other health care facility). Phase: Phase I and Phase II (Integrated)- Other. Countries: Germany (ongoing, recruiting).
Therapeutic area(s): Diseases [C] - Immune System Diseases [C20]
Gender: Female, Male. Age: 18-64 years, 65+ years. Enrolment: 12.
Status: Ongoing, recruiting. Start date (EU): 2025-07-30. Decision date: 2025-05-05. Results received: No. Last updated: 2026-05-29.
Decision dates by country: DE: 2025-07-02

Condition(s): Idiopathic inflammatory myositis, Systemic Lupus Erythematosus, Systemic Sclerosis
Product: ALDESLEUKIN, CNTY-101

Primary endpoint: Incidence of any GvHD, any grade ≥ 3 CRS or grade ≥ 3 ICANS, any grade ≥ 3 organ toxicity that does not resolve to grade ≤ 2 within 72 hours, any grade ≥ 3 immune effector cell-associated hemophagocytosis, grade ≥ 2 ICANS and CRS that does not resolve to grade 1 within 7 days following adequate therapy.

Source: https://euclinicaltrials.eu/ctis-public/view/2024-519532-16-00